EU clinical trial 2023-510268-11-00: A randomized, open label, phase II trial of Anti-PD1, dostarlimab (TSR-042), as maintenance therapy for patients with high-risk locally advanced cervical cancer after chemo-radiation
Protocol code: GEICO78-C (ATOMICC)
Sponsor: Grupo Espanol De Investigacion En Cancer De Ovario (Patient organisation/association). Phase: Therapeutic exploratory (Phase II). Countries: Spain (ongoing, recruitment ended).
Therapeutic area(s): Diseases [C] - Neoplasms [C04]
Gender: Female. Age: 18-64 years, 65+ years. Enrolment: 132.
Status: Ongoing, recruitment ended. Start date (EU): 2019-06-11. Decision date: 2024-03-08. Results received: No. Last updated: 2026-06-12.

Condition(s): Cervical cancer
Product: JEMPERLI 500 mg concentrate for solution for infusion

Primary endpoint: Progression Free Survival (PFS)
Endpoint(s): Overall survival (OS), Health-related quality of life (HRQOL) measure by the Functional Assessment of Cancer Therapy-Cervix (FACT-Cx) and EQ-5D-5L., Fatigue measure by the PROMIS-Cancer-Fatigue Short Form 4a, Pain measure by a single item of the Brief Pain Inventory (BPI).

Source: https://euclinicaltrials.eu/ctis-public/view/2023-510268-11-00